EU clinical trial 2023-509046-36-00: A Phase 3b Extension Study to Evaluate the Long-term Safety of Vedolizumab Intravenous in Pediatric Patients With Ulcerative Colitis or Crohn's Disease
Protocol code: MLN0002-3029
Sponsor: Takeda Development Center Americas Inc. (Pharmaceutical company). Phase: Therapeutic confirmatory (Phase III). Countries: Greece (ongoing, recruiting), Poland (ongoing, recruiting), Belgium (ongoing, recruiting), Croatia (ongoing, recruiting), Italy (ongoing, recruiting), Hungary (ongoing, recruiting).
Therapeutic area(s): Diseases [C] - Digestive System Diseases [C06]
Gender: Female, Male. Age: 0-17 years. Enrolment: 128.
Status: Ongoing, recruiting. Start date (EU): 2023-04-26. Decision date: 2024-07-30. Results received: No. Last updated: 2025-08-14.
Decision dates by country: PL: 2024-08-04, HR: 2024-08-06, IT: 2024-08-05, HU: 2024-07-31, BE: 2024-07-30, GR: 2024-08-01

Condition(s): Active Ulcerative Colitis (UC) or Crohn's disease (CD)
Product: PREDNISONE, Entyvio 300 mg powder for concentrate for solution for infusion

Primary endpoint: For the Treatment Cohort: The primary endpoint for this study is the incidence of adverse events (AEs)., For the Observational Cohort: Incidence of prespecified safety events (serious infections, malignancies, progressive multifocal leukoencephalopathy [PML], concerns about growth and pubertal development, and bowel surgery).
Endpoint(s): For the Treatment Cohort: • Time to major IBD-related events (eg, hospitalizations, surgeries, or procedures). • Changes from baseline of Studies MLN0002-3024 (UC) or MLN0002-3025 (CD) in IMPACT-III total and subscale scores for subjects aged 9 to 17 years as measured every 24 weeks.

Source: https://euclinicaltrials.eu/ctis-public/view/2023-509046-36-00